EU clinical trial 2023-508526-10-00: A First-in-Human, Open-label, Dose-escalation Trial With Expansion Cohorts to Evaluate Safety and Anti-tumor Activity of GEN1042 in Subjects With Malignant Solid Tumors
Protocol code: GCT1042-01
Sponsor: Genmab A/S (Pharmaceutical company). Phase: Phase I and Phase II (Integrated)- First administration to humans. Countries: France (ended), Italy (ongoing, recruitment ended), Germany (ongoing, recruitment ended), Spain (ongoing, recruitment ended), Denmark (ongoing, recruitment ended).
Therapeutic area(s): Diseases [C] - Neoplasms [C04]
Gender: Female, Male. Age: 18-64 years, 65+ years. Enrolment: 270.
Start date (EU): 2019-10-01. Decision date: 2024-06-19. Results received: No. Last updated: 2026-06-09.
Decision dates by country: FR: 2024-06-19, DE: 2024-06-24, DK: 2024-06-19, ES: 2024-06-21, IT: 2024-06-24

Condition(s): Malignant solid tumors: Patients with relapsed or refractory, advanced and/or metastatic melanoma, Non-Small Cell Lung Cancer (NSCLC), Head and neck squamous cell carcinoma (HNSCC), Panctreatic ductal adenocarcinoma (PDAC) or Colorectal Cancer (CRC).
Product: Abraxane 5 mg/ml powder for dispersion for infusion., PEMETREXED, GEN1042 DP, CARBOPLATIN, FLUOROURACIL, PACLITAXEL, PEMBROLIZUMAB, GEMCITABINE, CISPLATIN

Primary endpoint: For dose escalation and safety run-in: • Dose-limiting toxicity (DLT) For dose expansion as monotherapy and in combination: • Objective Response Rate (ORR) per Response Evaluation Criteria in Solid Tumors (RECIST) 1.1 by investigator assessment
Endpoint(s): - Adverse events (AEs) and safety laboratory parameters - ORR per RECIST 1.1 by investigator assessment (for dose escalation only) • Duration of response (DOR) per RECIST 1.1 by investigator assessment • Disease Control Rate (DCR) per RECIST 1.1 by investigator assessment • Progression-free survival (PFS) per RECIST 1.1 by investigator assessment • OS - PK parameters and anti-drug antibodies (ADAs)

Source: https://euclinicaltrials.eu/ctis-public/view/2023-508526-10-00